EU clinical trial 2024-512840-52-00: Evaluation of the efficacy and safety of empagliflozin in the treatment of neutropenia in patients with glycogenosis Ib. EMPAtia.
Protocol code: EMPAtia
Sponsor: Instytut Pomnik Centrum Zdrowia Dziecka (Hospital/Clinic/Other health care facility). Phase: Therapeutic exploratory (Phase II). Countries: Poland (ended).
Therapeutic area(s): Phenomena and Processes [G] - Metabolism [G03]
Gender: Female, Male. Age: 0-17 years, 18-64 years, 65+ years. Enrolment: 20.
Status: Ended. Start date (EU): 2022-03-03. End date (EU): 2025-04-03. Decision date: 2024-12-02. Results received: No. Last updated: 2024-12-02.

Condition(s): Glycogenosis type Ib is an ultra-rare disease, inherited in an autosomal recessive manner.
Product: Jardiance 10 mg film-coated tablets

Primary endpoint: The primary endpoint will be an assessment of the safety and tolerability of empagliflozin, expressed as the type and frequency of adverse reactions throughout the study period. Safety data will be collected at all visits and will be related to possible adverse reactions to empagliflozin as described in the summary of product characteristics.
Endpoint(s): The secondary objective is to assess efficacy expressed as restoration of neutrophil numbers and function

Source: https://euclinicaltrials.eu/ctis-public/view/2024-512840-52-00